EU clinical trial 2024-511350-41-00: Phase 1/2 Dose Determination and Dose Expansion Study of Cobolimab in Combination with Dostarlimab in Pediatric and Young Adult Participants with Newly Diagnosed and Relapsed/Refractory Tumors (POPSTAR)
Protocol code: 219451
Sponsor: Glaxosmithkline Research & Development Limited (Pharmaceutical company). Phase: Phase I and Phase II (Integrated)- Other. Countries: Spain (ended), France (ended), Germany (ended), Denmark (ended), Italy (ended), Czechia (ended).
Therapeutic area(s): Diseases [C] - Neoplasms [C04]
Gender: Female, Male. Age: 0-17 years, 18-64 years. Enrolment: 46.
Status: Ended. Start date (EU): 2025-03-13. End date (EU): 2026-05-18. End date: 2026-05-18. Decision date: 2024-10-21. Results received: No. Last updated: 2025-12-10.
Decision dates by country: IT: 2024-10-23, CZ: 2024-10-24, DE: 2024-10-25, FR: 2024-10-24, DK: 2024-10-21, ES: 2024-10-23

Condition(s): Relapsed/Refractory Tumors
Product: JEMPERLI 500 mg concentrate for solution for infusion

Primary endpoint: Part 1: • Incidence of DLTs. • Incidence of TEAEs, SAEs, imAEs and AEs leading discontinuation occurring during the study. • IMP serum concentrations up to Cycle 6. • RP2D., Part 2: • Confirmed ORR. • The incidence of TEAEs, SAEs, imAEs, TEAEs leading to death, and AEs leading to discontinuation occurring while participants are on treatment or up to 90 days after the last dose of study treatment. • Change in safety assessments (laboratory parameters, vital signs, cardiac parameters).
Endpoint(s): Part 1: Receptor occupancy measured in whole blood as normalized free-to-total TIM-3 receptor ratio., Part 1: • Confirmed ORR, • PFS, • DOR, • OS., Part 1: Incidence and titers of ADAs against cobolimab and dostarlimab., Part 2: • PFS, • DOR, • OS., Part 2: Cobolimab and dostarlimab serum concentrations., Part 2: Receptor occupancy measured in whole blood as normalized free-to-total TIM-3 receptor ratio., Part 2: Incidence and titers of ADAs against cobolimab and dostarlimab.

Source: https://euclinicaltrials.eu/ctis-public/view/2024-511350-41-00